EU clinical trial 2024-515941-40-00: Randomized Clinical Trial for the Treatment of Lateral Epicondylitis with Debridement Arthroscopic Versus Cytokine-Rich Autologous Serum. (SARC)
Sponsor: Parc Tauli Hospital Universitari (Hospital/Clinic/Other health care facility). Phase: Therapeutic use (Phase IV). Countries: Spain (authorised, recruitment pending).
Therapeutic area(s): Diseases [C] - Musculoskeletal Diseases [C05]
Gender: Female, Male. Age: 18-64 years, 65+ years. Enrolment: 86.
Status: Authorised, recruitment pending. Decision date: 2024-11-20. Results received: No. Last updated: 2024-11-20.

Condition(s): Epicondylitis
Product: PLATELET CONCENTRATE

Primary endpoint: In the case of the group of patients treated with SARC, the treatment consists of 2 infiltrations at an interval of 14 to 21 days. If, due to medical criteria, the researcher decides to perform a single infiltration, will consider that the subject has been withdrawn from treatment. However, it will carry out the same monitoring and control visits as for the rest of the patients.
Endpoint(s): Unexpected systemic infections or infections in the infiltration zone or fever related to suspected infection., Anaphylactic shock or other serious toxicities related to the treatment. Treatment will be restarted at the discretion of the investigators., Edema in the treated area not associated with infiltration. It will restart the treatment according to the investigators' criteria.

Source: https://euclinicaltrials.eu/ctis-public/view/2024-515941-40-00